EU clinical trial 2024-520089-70-00: LEISURE : Lenalidomide vs methotrexate in difficult-to-treat cutaneous lupus erythematosus (LEISURE trial): An assessor-blinded randomized clinical trial
Protocol code: APHP240920
Sponsor: Assistance Publique Hopitaux De Paris (Hospital/Clinic/Other health care facility). Phase: Therapeutic confirmatory (Phase III). Countries: France (ongoing, recruiting).
Therapeutic area(s): Diseases [C] - Skin and Connective Tissue Diseases [C17]
Gender: Female, Male. Age: 18-64 years, 65+ years. Enrolment: 122.
Status: Ongoing, recruiting. Start date (EU): 2026-07-29. Decision date: 2025-11-14. Results received: No. Last updated: 2026-03-24.

Condition(s): Cutaneous lupus erythematosus
Product: METHOTREXATE, LENALIDOMIDE, LENALIDOMIDE

Primary endpoint: The primary endpoint will be the proportion of patients who achieve decrease of at least 50% from baseline in the CLASI activity (CLASI-A) score (CLASI-A 50 response) at week 16 with at least 8 of CLASI-A at baseline.
Endpoint(s): Percentage of patients reaching CLASI-A 70, a 70% decrease from baseline CLASI-A at week 16, Proportion of participants who achieve complete or almost complete response (CLASI-A 0-3) at week 16, Percentage of patients reaching CLASI-A 70, a 70% decrease from baseline CLASI-A at week 24, Proportion of participants who achieve complete or almost complete response (CLASI-A 0-3) at week 24, Variation of Quality of life using DLQI at week 16, Variation of Quality of life using DLQI at week 24, SLE activity using SLEDAI at each visit, SLE flare using SENELA-SLEDAI Flare Index (SFI) at each visit, Variation of GCs dose between inclusion and week 24., Variation of damage in each group using CLASI-D at week 24, Variation of damage in each group using CLASI-D at week 16, Rate of adverse events during the treatment and the follow-up periods

Source: https://euclinicaltrials.eu/ctis-public/view/2024-520089-70-00